EU clinical trial 2025-522074-37-00: A PHASE 2A, OPEN-LABEL SINGLE ARM MULTICENTER EXPLORATORY STUDY TO EVALUATE THE SAFETY, TOLERABILITY, AND EFFICACY OF ORAL DOSES OF ROC-101 IN PATIENTS WITH PULMONARY ARTERIAL HYPERTENSION (PAH) AND PULMONARY HYPERTENSION ASSOCIATED WITH INTERSTITIAL LUNG DISEASE (ILD-PH)
Protocol code: ROC-101-201
Sponsor: Allrock Bio Inc. (Pharmaceutical company). Phase: Therapeutic exploratory (Phase II). Countries: Spain (ongoing, recruiting), Italy (ongoing, recruiting), Poland (authorised, recruitment pending), France (ongoing, recruiting), Latvia (ongoing, recruiting), Germany (authorised, recruiting).
Therapeutic area(s): Diseases [C] - Cardiovascular Diseases [C14]
Gender: Female, Male. Age: 18-64 years, 65+ years. Enrolment: 21.
Start date (EU): 2026-02-19. Decision date: 2025-12-04. Results received: No. Last updated: 2025-12-22.
Decision dates by country: FR: 2025-12-10, DE: 2025-12-17, IT: 2025-12-16, LV: 2025-12-04, ES: 2025-12-15, PL: 2025-12-22

Condition(s): Pulmonary Arterial Hypertension (PAH), Pulmonary Hypertension Associated with Interstitial Lung Disease (ILD-PH)
Product: ROC-101

Primary endpoint: 1. Change in PVR from Baseline versus at 24 weeks, 2. Safety assessments, including adverse events (AEs), vital signs (body temperature, heart rate [HR] and blood pressure [BP], respiratory rate [RR], fraction of inspired oxygen [FiO2] and saturation of peripheral oxygen [SpO2]), 12-lead electrocardiograms (ECG) and safety laboratory tests
Endpoint(s): 1. Change in 6MWD from Baseline versus at 24 weeks, 2. Change in NT-proBNP from Baseline versus at 24 weeks, 3. Change in WHO FC from Baseline versus at 24 weeks, 4. Change in right atrial pressure (RAP), mean pulmonary artery pressure (mPAP), cardiac output (CO), cardiac index (CI), pulmonary capillary wedge pressure (PCWP), mixed venous oxygen saturation (SvO2), stroke volume (SV) SV index (SVI), pulse pressure (PP), and pulmonary artery compliance (PAC) from Screening versus at 24 weeks

Source: https://euclinicaltrials.eu/ctis-public/view/2025-522074-37-00